EU clinical trial 2025-523020-50-00: A Phase 2a, Randomized, Double-Blind, Parallel-Group, Placebo Controlled Study to Evaluate the Efficacy, Safety, and Tolerability of Fexlamose (AER 01) Inhalation Solution in the Treatment of Adults with Moderate to Severe Chronic Obstructive Pulmonary Disease
Protocol code: AER-01-002
Sponsor: Aer Therapeutics Inc. (Pharmaceutical company). Phase: Therapeutic exploratory (Phase II). Countries: Bulgaria (ongoing, recruitment ended), Poland (ongoing, recruitment ended), Spain (ongoing, recruitment ended).
Therapeutic area(s): Diseases [C] - Respiratory Tract Diseases [C08]
Gender: Female, Male. Age: 18-64 years, 65+ years. Enrolment: 90.
Status: Ongoing, recruitment ended. Start date (EU): 2026-03-04. Decision date: 2026-01-16. Results received: No. Last updated: 2026-06-01.
Decision dates by country: ES: 2026-03-06, PL: 2026-01-19, BG: 2026-01-19

Condition(s): Chronic Obstructive Pulmonary Disease
Product: Placebo inhalation solution is manufactured as a sterile, single-dose, preservative-free aqueous solution., Fexlamose

Primary endpoint: • Change from baseline in prebronchodilator FEV1 at Week 4
Endpoint(s): 1. Change from baseline in CT MPSS at w 4, 2. Percentage of participants who have treatment related reduction of MPSS, 3. Change from baseline in SGRQ-C at w 4, 4. Percentage of participants with ≥4 unit decrease from baseline in SGRQ-C at w 4, 5. Change from baseline in prebronchodilator FVC at w 4, 6. Change from baseline in SpO2 at w 4, 7. Incidence of AEs throughout the study, 8. Hematology, biochemistry, and urinalysis parameters assessed throughout the study, 9. Incidence of GGO as detected by CT lung scan at w 4

Source: https://euclinicaltrials.eu/ctis-public/view/2025-523020-50-00